EU clinical trial 2024-510915-31-00: A Phase 1, Randomized, Open Label, Single-Dose Crossover Study to Assess the Relative Bioavailability, Food Effect, and Safety of Capsule Formulations of INF904.
Protocol code: INF904-P1.3
Sponsor: InflaRx GmbH (Pharmaceutical company). Phase: Human Pharmacology (Phase I)- Other. Countries: Netherlands (ended).
Therapeutic area(s): Not possible to specify
Gender: Female, Male. Age: 18-64 years. Enrolment: 51.
Status: Ended. Start date (EU): 2024-06-14. End date (EU): 2025-04-16. Decision date: 2024-06-13. Results received: No. Last updated: 2025-03-28.

Condition(s): Not applicable, healthy volunteers

Source: https://euclinicaltrials.eu/ctis-public/view/2024-510915-31-00